EU clinical trial 2025-520464-17-00: A Multicenter, Double-Blind, Randomized, Placebo-Controlled Study of Orticumab in Participants with Prior Myocardial Infarction who have Elevated Coronary Inflammation Based on Fat Attenuation Index (FAI) Score Assessed by Coronary Computed Tomography Angiography (CCTA)
Protocol code: ORT-2024-02
Sponsor: Abcentra LLC (Pharmaceutical company). Phase: Therapeutic exploratory (Phase II). Countries: Czechia (ongoing, recruiting), Sweden (ongoing, recruiting), Hungary (ongoing, recruiting), Italy (ongoing, recruiting), Poland (ongoing, recruiting), Spain (ongoing, recruiting), Romania (ongoing, recruiting).
Therapeutic area(s): Diseases [C] - Cardiovascular Diseases [C14]
Gender: Female, Male. Age: 18-64 years, 65+ years. Enrolment: 184.
Status: Ongoing, recruiting. Start date (EU): 2025-10-21. Decision date: 2025-08-13. Results received: No. Last updated: 2026-08-07.
Decision dates by country: HU: 2025-08-22, IT: 2025-08-13, SE: 2025-08-18, ES: 2025-08-13, CZ: 2025-08-19, PL: 2025-08-22, RO: 2025-08-25

Condition(s): Atherosclerotic Cardiovascular disease
Product: Placebo matching orticumab, Orticumab

Primary endpoint: Percent change from baseline of the mean Fat Attenuation Index (FAI) score for the 3 coronary arteries (RCA, LAD, LCX), calculated as the average of the analyzable FAI scores (valid baseline and post-baseline FAI score) across the three main coronary arteries, for orticumab compared to placebo after 6 months of treatment
Endpoint(s): 1. Change from baseline for FAI, FAI score (mean absolute change and mean percent change) and FAI score centile for orticumab compared to placebo after 6 months of treatment in the following vessels: o Greatest change in most inflamed vessel o Greatest change in any vessel o RCA only analysis o LAD only analysis o LCX only analysis, 2. Mean absolute change from baseline for mean FAI and mean FAI score, defined as the average of the analyzable vessels (with valid baseline FAI and post-baseline FAI) across the three main coronary arteries (RCA, LAD, LCX), 3. Change from baseline for CaRi-Heart risk score (mean absolute change and mean percent change) for orticumab compared to placebo after 6 months of treatment, 4. Number and percent of participants with treatment-emergent adverse events (TEAEs), and any serious adverse events, 5. Change from baseline in systolic blood pressure, diastolic blood pressure and pulse rate measurements, 6. Change from baseline in clinical safety laboratory parameters, 7. Change from baseline in physical examinations, 8. Serum ADA titers measured at baseline and at specified times over the 6-month treatment period, 9. Serum trough orticumab concentrations following an orticumab dose

Source: https://euclinicaltrials.eu/ctis-public/view/2025-520464-17-00